EU clinical trial 2022-501363-40-00: A Phase 1 Study of the SHP2 Inhibitor BBP-398 (formerly known as IACS-15509) in combination with the KRAS-G12C Inhibitor Sotorasib in Patients with Advanced Solid Tumors and a KRAS-G12C Mutation
Protocol code: NAV-1003
Sponsor: Navire Pharma Inc. (Pharmaceutical company). Phase: Human Pharmacology (Phase I)- Other. Countries: Netherlands (ended), Spain (ended), France (ended), Italy (ended), Belgium (ended), Denmark (ended), Greece (ended).
Therapeutic area(s): Diseases [C] - Neoplasms [C04]
Gender: Female, Male. Age: 18-64 years, 65+ years. Enrolment: 75.
Status: Ended. Start date (EU): 2023-03-17. End date (EU): 2024-04-09. End date: 2024-08-22. Decision date: 2023-01-12. Results received: No. Last updated: 2024-05-20.
Decision dates by country: DK: 2023-07-10, ES: 2023-01-12, BE: 2023-07-18, GR: 2023-07-10, NL: 2023-01-12, FR: 2023-01-12, IT: 2023-01-13

Condition(s): Advanced or metastatic solid tumors with a KRAS-G12C mutation, Advanced or metastatic non-small cell lung cancer (NSCLC) with a KRAS-G12C mutation and who are KRAS-G12Ci naïve

Source: https://euclinicaltrials.eu/ctis-public/view/2022-501363-40-00